EU clinical trial 2022-502654-14-00: A multicenter, open-label, phase 2, basket study to evaluate the efficacy and safety of SKB264 in combination with pembrolizumab in subjects with selected solid tumors
Protocol code: SKB264-II-06
Sponsor: Sichuan Kelun-Biotech Biopharmaceutical Co. Ltd. (Pharmaceutical company). Phase: Therapeutic exploratory (Phase II). Countries: France (ended), Belgium (ended), Spain (ended), Poland (ongoing, recruitment ended).
Therapeutic area(s): Diseases [C] - Neoplasms [C04]
Gender: Female, Male. Age: 18-64 years, 65+ years. Enrolment: 101.
Start date (EU): 2023-09-11. Decision date: 2023-06-13. Results received: No. Last updated: 2026-05-19.
Decision dates by country: FR: 2023-06-14, ES: 2023-10-26, BE: 2023-06-13, PL: 2023-06-19

Condition(s): Endometrial cancer, Cervical cancer, Prostate cancer, Urothelial carcinoma, Ovarian cancer
Product: PARACETAMOL, KEYTRUDA 25 mg/mL concentrate for solution for infusion, SKB264

Primary endpoint: The primary study endpoints of safety are the number of subjects with dose-limiting toxicities (side effects due to the study drug), number of subjects with adverse events (any side effects related or unrelated to the study drug) and number of subjects discontinuing the study drug due to adverse events., The primary study endpoints of efficacy are the proportion of subjects with a confirmed complete response or partial response and the percentage of subjects who have a negative change (decrease) in prostate-specific antigen level (a type of protein produced by prostate gland in men).
Endpoint(s): Vital signs, physical examination, laboratory tests, 12-lead electrocardiogram/ echocardiogram/multiple-gated acquisition scan (MUGA), and eastern cooperative oncology group performance status. These tests will be done to assess the safety of SKB264 in combination with pembrolizumab., The disease control rate, duration of response, progressionfree survival, and overall survival. These are the tests to assess the antitumor activity (preventing or inhibiting the formation or growth of tumors) of SKB264 in combination with pembrolizumab, Area under the serum concentration curve (AUC): AUC shows how much drug has entered the blood over a period of time., Minimum serum concentration (Cmin): Cmin is the least amount of drug that remains in blood after one dose is given., Maximum serum concentration (Cmax): Cmax shows the most amount of drug found in blood after one dose is given., Test for presence of antibodies against the study drug. Number of subjects with positive anti-drug antibodies (ADA) test., ADA titers (concentration of ADA in blood)

Source: https://euclinicaltrials.eu/ctis-public/view/2022-502654-14-00